EU clinical trial 2024-515045-42-00: A multicenter single-arm pilot study of ramucirumab in combination with dacarbazine in patients with progressive well differentiated metastatic pancreatic neuroendocrine tumors
Sponsor: Martin-Luther-Universitaet Halle-Wittenberg (Educational Institution). Phase: Therapeutic exploratory (Phase II). Countries: Germany (ended).
Therapeutic area(s): Diseases [C] - Neoplasms [C04]
Gender: Female, Male. Age: 18-64 years, 65+ years. Enrolment: 45.
Status: Ended. Start date (EU): 2018-04-23. End date (EU): 2025-06-06. Decision date: 2024-10-11. Results received: Yes. Last updated: 2024-10-11.

Condition(s): Progressive well-differentiated metastatic neuroendocrine tumors of the pancreas
Product: Cyramza 10 mg/ml concentrate for solution for infusion

Primary endpoint: Disease control rate (DCR) after 6 months from study entry, determined according to RECIST 1.1 or death
Endpoint(s): - Objective tumor response (ORR) - progression-free survival (PFS) - overall survival (OS) - toxicity - biochemical response (tumor marker chromogranin A; in cases of functional NET: gastrin, insulin) - Quality of Life (EORTC QLQ-C30 questionnaire) Translational research: - Predictive biomarkers (circulating VEGF, ANGPT1/2 and IL8 levels, immunohistochemical VEGFR2 expression)

Source: https://euclinicaltrials.eu/ctis-public/view/2024-515045-42-00